EU clinical trial 2024-514437-37-00: A study to assess the safety and anti-tumor activity of T cell therapy in subjects with advanced liver cancer or any other AFP expressing tumor types
Protocol code: ADP-0033-001
Sponsor: Adaptimmune LLC (Pharmaceutical company). Phase: Human Pharmacology (Phase I)- First administration to humans. Countries: Spain (ended), France (ended).
Therapeutic area(s): Diseases [C] - Neoplasms [C04]
Gender: Female, Male. Age: 18-64 years, 65+ years. Enrolment: 14.
Status: Ended. Start date (EU): 2018-02-22. End date (EU): 2025-09-04. End date: 2025-09-05. Decision date: 2024-08-26. Results received: No. Last updated: 2024-09-26.
Decision dates by country: FR: 2024-09-26, ES: 2024-08-26

Condition(s): Advanced Hepatocellular Carcinoma (HCC) that is not amenable to transplant or resection. Loco-regional therapy is allowed until lymphodepletion.

Source: https://euclinicaltrials.eu/ctis-public/view/2024-514437-37-00